EU clinical trial 2024-513779-42-02: Precision cancer medicine in hard-to-treat rare cancers - repurposing drugs in earlier lines of treatment - MATRIX-RARE.
Sponsor: Oslo University Hospital HF (Hospital/Clinic/Other health care facility). Phase: Therapeutic exploratory (Phase II). Countries: Norway (ongoing, recruiting).
Therapeutic area(s): Diseases [C] - Neoplasms [C04]
Gender: Female, Male. Age: 18-64 years, 65+ years. Enrolment: 100.
Status: Ongoing, recruiting. Start date (EU): 2025-03-27. Decision date: 2025-02-12. Results received: No. Last updated: 2026-05-29.

Condition(s): Cancer
Product: Tevimbra 100 mg concentrate for solution for infusion, Voranigo 40 mg film-coated tablets, Temodal 140 mg hard capsules, Spexotras 0.05 mg/ml powder for oral solution, Mekinist 0.5 mg film-coated tablets, Temodal 180 mg hard capsules, Temodal 250 mg hard capsules, Temodal 2.5 mg/ml powder for solution for infusion, Temodal 20 mg hard capsules, Temodal 100 mg hard capsules, Tafinlar 75 mg hard capsules, Tafinlar 50 mg hard capsules, Tibsovo 250 mg film-coated tablets, Tafinlar 75 mg hard capsules, Tevimbra 100 mg concentrate for solution for infusion, Voranigo 10 mg film-coated tablets, Tafinlar 50 mg hard capsules, Tevimbra 100 mg concentrate for solution for infusion, Mekinist 2 mg film-coated tablets, Tevimbra 100 mg concentrate for solution for infusion, IMATINIB, Finlee 10 mg dispersible tablets, IMATINIB

Primary endpoint: 1) Disease control (objective complete or partial response or stable disease) at 16 weeks after treatment initiation according to established response criteria, 2) Treatment-related grade ≥3 and serious adverse events for all cohorts., 3. Treatment-related grade 1-5 adverse events for cohorts with new treatment combinations
Endpoint(s): 1) Progression-free survival, 2) Overall survival, Duration of time on drug

Source: https://euclinicaltrials.eu/ctis-public/view/2024-513779-42-02